EU clinical trial 2024-519753-11-00: PRODIGE 104 – NEOPREDICT A multicenter phase II trial using transcriptomic signatures to personalize neoadjuvant chemotherapy for patients with resectable borderline pancreatic adenocarcinoma.
Protocol code: PRODIGE 104 A
Sponsor: Fondation Franc.Cancerologie Digestive (Hospital/Clinic/Other health care facility). Phase: Therapeutic exploratory (Phase II). Countries: France (authorised, recruitment pending).
Therapeutic area(s): Diseases [C] - Digestive System Diseases [C06]
Gender: Female, Male. Age: 18-64 years, 65+ years. Enrolment: 110.
Status: Authorised, recruitment pending. Decision date: 2025-10-17. Results received: No. Last updated: 2025-10-17.

Condition(s): Resectable borderline pancreatic adenocarcinoma
Product: Apexelsin 5 mg/ml powder for dispersion for infusion., FOLINATE DE CALCIUM HIKMA 10 mg/mL, solution injectable/pour perfusion, OXALIPLATINE KABI 5 mg/ml, solution à diluer pour perfusion., GEMCITABINE HIKMA 38 mg/ml, solution à diluer pour perfusion, FLUOROURACILE TEVA 5000 mg/100 ml, solution à diluer pour perfusion, IRINOTECAN MEDAC 20 mg/ml, solution à diluer pour perfusion

Primary endpoint: 1-year EFS in the GEM + randomized population
Endpoint(s): ORR is defined as % of patients with a complete or a partial response, TRG evaluated by Ryan Simplified TRG on the primary tumor after surgery., Resection rates will be evaluated after 4 months of neoadjuvant chemotherapy in both arms, OS is defined as the time between the date of randomization and the date of death (whatever the cause), PFS is defined as the time between the date of randomization and the date of first recurrence or death (all causes). PFS will be evaluated on patients without resection, DFS is defined as the time between the date of randomization and the date of first recurrence or death. DFS will be evaluated on patients with resection, TTR is defined as the time between the date of randomization and the date of first recurrence or death linked to the cancer, Percentage of NAC completion (4 months planned) is defined as the percentage of patients who received the 4 cycles of NAC, Percentage of adjuvant chemotherapy is defined as the percentage of patients who received at least one dose of adjuvant chemotherapy, Toxicities during the NAC will be collected before each NA cycle and will be graded according to NCI-CTCAE v5.0, Quality of life will be assessed with QLQC30 and QLQPAN26. It is defined as the time between the date of randomization and the date of death or date of first deterioration by more than five points on the global health scale in comparison with the score at baseline

Source: https://euclinicaltrials.eu/ctis-public/view/2024-519753-11-00